EU clinical trial 2025-523742-27-00: A Phase Ib/II, Multicenter, Open-Label Study to Evaluate Safety, Efficacy, and Pharmacokinetics of YL201 in Combination with Other Anti-Cancer Therapies in Patients with Advanced Solid Tumors
Protocol code: YL201-INT-102-02
Sponsor: Medilink Therapeutics (Suzhou) Co. Ltd. (Pharmaceutical company). Phase: Phase I and Phase II (Integrated)- Other. Countries: Poland (ongoing, recruiting), Spain (ongoing, recruiting), France (authorised, recruiting), Romania (authorised, recruiting), Italy (ongoing, recruiting), Belgium (authorised, recruiting), Hungary (authorised, recruiting), Germany (authorised, recruitment pending).
Therapeutic area(s): Diseases [C] - Neoplasms [C04]
Gender: Female, Male. Age: 18-64 years, 65+ years. Enrolment: 133.
Start date (EU): 2026-04-28. Decision date: 2026-03-17. Results received: No. Last updated: 2026-03-27.
Decision dates by country: BE: 2026-03-18, FR: 2026-03-20, DE: 2026-03-17, HU: 2026-03-18, IT: 2026-03-18, RO: 2026-03-23, ES: 2026-03-23, PL: 2026-03-23

Condition(s): Advanced solid tumors
Product: Tecentriq 1 200 mg concentrate for solution for infusion, YL201

Primary endpoint: Part 1 Primary Endpoints • AEs, laboratory abnormalities and DLTs, Part 2 Primary Endpoints • ORR: assessed using RECIST version 1.1 • PFS: assessed using RECIST version 1.1
Endpoint(s): Part 1: Secondary Endpoints • PK parameters • Incidence of anti-YL201 antibodies • ORR: assessed using RECIST version 1.1, Part 2: • AEs and laboratory abnormalities • PK parameters • Incidence of anti-YL201 antibodies • DOR: assessed using RECIST version 1.1 • OS

Source: https://euclinicaltrials.eu/ctis-public/view/2025-523742-27-00